EU clinical trial 2023-505424-57-00: A controlled, randomized, first-in-human study of AP31969 investigating single and multiple ascending doses and the effect of food in healthy subjects
Protocol code: AP31969-M101
Sponsor: Acesion Pharma ApS (Pharmaceutical company). Phase: Human Pharmacology (Phase I)- First administration to humans. Countries: Netherlands (ended).
Therapeutic area(s): Diseases [C] - Cardiovascular Diseases [C14]
Gender: Female, Male. Age: 18-64 years. Enrolment: 142.
Status: Ended. Start date (EU): 2023-10-04. End date (EU): 2025-03-14. Decision date: 2023-08-28. Results received: No. Last updated: 2024-12-13.

Condition(s): Atrial Fibrillation (cardiac arrhythmia)

Source: https://euclinicaltrials.eu/ctis-public/view/2023-505424-57-00